EU clinical trial 2025-521989-95-00: Phase 1b/2 Trial of OMTX705, an Anti-Fibroblast Activation Protein Antibody-Drug Conjugate, in Combination with Carboplatin, Pemetrexed and Tislelizumab in Patients with Advanced/Metastatic Non-squamous Non-Small Cell Lung Cancer
Protocol code: OMTX705-005
Sponsor: Oncomatryx Biopharma S.L. (Pharmaceutical company). Phase: Phase I and Phase II (Integrated)- Other. Countries: Spain (authorised, recruitment pending).
Therapeutic area(s): Diseases [C] - Neoplasms [C04]
Gender: Female, Male. Age: 18-64 years. Enrolment: 88.
Status: Authorised, recruitment pending. Decision date: 2025-12-12. Results received: No. Last updated: 2025-12-12.

Condition(s): Advanced/Metastatic Non-squamous Non-Small Cell Lung Cancer
Product: Pemetrexed EVER Pharma 25 mg/ml concentrate for solution for infusion, Carboplatino Aurovitas 10 mg/ml concentrado para solución para perfusión EFG, Pemetrexed Accord 25 mg/ml concentrate for solution for infusion, Pemetrexed Glenmark 10 mg/ml solución para perfusión, Carboplatino Hikma 10 mg/ml soluzione per infusione, OMTX705, Pemetrexed Accord 25 mg/ml concentrate for solution for infusion, Carboplatino Teva 10 mg/ml Concentrado para solución para perfusión, Carboplatino Accord 10 mg/ml concentrado para solución para perfusión EFG, Tevimbra 100 mg concentrate for solution for infusion, Carboplatino Hikma 10 mg/ml soluzione per infusione

Primary endpoint: Part 1: The safety and tolerability of OMTX705 in combination with tislelizumab, carboplatin and pemetrexed will be assessed by: • The nature and frequency of DLTs. • Frequency, duration, and severity of treatment emerging adverse events (TEAEs) per Common Terminology Criteria for Adverse Events version 5.0 (CTCAE v5.0)., • Changes in vital signs, serum chemistry and hematology. • Treatment modifications condensed as percentage of relative dose intensity and other dose endpoints. • The MTD dose or recommended Part 2 dose., Part 2: Objective response rate (ORR), as determined by the Investigator, according to Response Evaluation Criteria in Solid Tumors, version 1.1 (RECIST 1.1).
Endpoint(s): Part 1 and 2: Additional efficacy endpoints will be evaluated by using RECIST 1.1: • Response-associated endpoints: disease control rate (DCR)=complete response (CR) + partial response (PR) + stable disease (SD) ≥ 1st, 2nd and 3rd postbaseline computed tomography scan evaluation, duration of response (DoR), and time to response., • Time-to-event efficacy endpoints: progression-free survival (PFS), proportion of participants without progression/death at 3, 6, and 12 months and every 3 months thereafter. Overall survival (OS) and proportion of participants alive at 3, 6, 12, 18 and 24 months., Additional safety data will be evaluated by assessing: • Frequency, duration, seriousness, relatedness, and severity of TEAEs, per CTCAE v5.0 • Changes in vital signs, serum chemistry and hematology. • Treatment modifications condensed as percentage of relative dose intensity and other dose endpoints., Part 1 and Part 2 immunogenicity of OMTX705 will be assessed by: • Quantification (titer) of anti-drug antibodies (ADAs) against OMTX705 and percentage of ADA positive participants., Part 1 and Part 2 pharmacokinetics profile of OMTX705 with pemetrexed/carboplatin /tislelizumab: • Blood concentrations of conjugated antibody and unconjugated payload (TAM470) listed and summarized using descriptive statistics.

Source: https://euclinicaltrials.eu/ctis-public/view/2025-521989-95-00